EU clinical trial 2025-521152-34-00: The SOUND-MCL study: A single-arm, open-label, multicenter, phase II study of acalabrutinib, in combination with the R-CHOP standard of care, for previously untreated mantle cell lymphoma in Spain
Protocol code: D8220L00087
Sponsor: Astrazeneca Farmaceutica Spain S.A. (Pharmaceutical company). Phase: Therapeutic exploratory (Phase II). Countries: Spain (ongoing, recruiting).
Therapeutic area(s): Diseases [C] - Hemic and Lymphatic Diseases [C15]
Gender: Female, Male. Age: 18-64 years, 65+ years. Enrolment: 55.
Status: Ongoing, recruiting. Start date (EU): 2025-09-04. Decision date: 2025-06-16. Results received: No. Last updated: 2026-06-19.

Condition(s): mantle cell lymphoma (MCL)
Product: Calquence 100 mg film-coated tablets

Primary endpoint: Investigator-assessed best ORR (CR+PR) as per the Lugano Classification for NHL. Timeframe: 1 year
Endpoint(s): TTR, defined as the time from the date of acalabrutinib start to the first investigator-assessed CR or PR per the Lugano Classification for NHL. Measure of interest: median TTR., DoR, defined as the time from the first documentation of investigator-assessed CR or PR to disease progression per the Lugano Classification for NHL or death from any cause in the absence of disease progression. Measure of interest: 30-month DoR, PFS, defined as the time from the date of acalabrutinib start to investigator-assessed disease progression as per the Lugano Classification for NHL or death from any cause, whichever occurs first. Measure of interest: 30-month PFS., OS, defined as the time from the date of acalabrutinib start to the date of death from any cause. Measure of interest: 30-month OS, Describe the number and percentage of patients with each MedDRA coded and CTCAE graded adverse (AEs) and serious adverse events (SAEs)., Incidence of AEs of clinical interest for acalabrutinib., Incidence of grade ≥3 AEs., Incidence of AEs leading to acalabrutinib dose modification, temporary interruption or permanent discontinuation.

Source: https://euclinicaltrials.eu/ctis-public/view/2025-521152-34-00